EU clinical trial 2025-524675-23-00: Switching to Mesalazine Monotherapy vs Continuing Thiopurines in Older Patients with Ulcerative Colitis in Sustained Remission: A Multicenter Randomized Controlled Trial (IDEA).
Protocol code: IDEA
Sponsor: Grupo Espanol De Trabajo En Enfermedad De Crohn y Colitis Ulcerosa (Patient organisation/association). Phase: Therapeutic use (Phase IV). Countries: Spain (ongoing, recruiting).
Therapeutic area(s): Diseases [C] - Digestive System Diseases [C06]
Gender: Female, Male. Age: 18-64 years, 65+ years. Enrolment: 304.
Status: Ongoing, recruiting. Start date (EU): 2026-06-24. Decision date: 2026-04-30. Results received: No. Last updated: 2026-04-30.

Condition(s): Ulcerative Colitis
Product: Salofalk 1000 mg granulado de liberación prolongada, Pentasa 4 g granulado de liberación prolongada, Asacol 1600 mg comprimidos gastrorresistentes, Claversal 500 mg comprimidos gastrorresistentes, Asacol 800 mg comprimidos gastrorresistentes, PENTASA 500 mg comprimidos de liberación prolongada, Pentasa 4 g granulado de liberación prolongada, Pentasa 1g granulado de liberación prolongada, PENTASA 500 mg comprimidos de liberación prolongada, Pentasa 2g granulado de liberación prolongada, Asacol 1600 mg comprimidos gastrorresistentes, Pentasa 1g granulado de liberación prolongada, Pentasa 1g granulado de liberación prolongada, Salofalk 3 g granulado de liberación prolongada, Pentasa 2g granulado de liberación prolongada, PENTASA 500 mg comprimidos de liberación prolongada, Claversal 1 g comprimidos gastrorresistentes, PENTASA1 g comprimidos de liberación prolongada, Pentasa 4 g granulado de liberación prolongada, Pentasa 4 g granulado de liberación prolongada, PENTASA 500 mg comprimidos de liberación prolongada

Primary endpoint: Biological recurrence: faecal calprotectin >250 µg/g confirmed in two consecutive samples OR clinical recurrence requiring intensification of treatment within 24 months.
Endpoint(s): Time to relapse, Clinical recurrence rate, Colectomy rate, Safety and adverse events, Mortality, Hospitalisation rate (due to activity or adverse events), Treatment adherence (Morisky-Green scale)

Source: https://euclinicaltrials.eu/ctis-public/view/2025-524675-23-00